EU clinical trial 2023-508214-42-00: A Phase 3 Multicenter, Randomized, Open Label, Active-controlled, Study of AMG 510 Versus Docetaxel for the Treatment of Previously Treated Locally Advanced and Unresectable or Metastatic NSCLC Subjects With Mutated KRAS p.G12C
Protocol code: 20190009
Sponsor: Amgen Inc. (Pharmaceutical company). Phase: Therapeutic confirmatory (Phase III). Countries: Germany (ended), Italy (ended), Poland (ended), Netherlands (ended), Spain (ended), Sweden (ended), Greece (ended), France (ended).
Therapeutic area(s): Diseases [C] - Neoplasms [C04]
Gender: Female, Male. Age: 18-64 years, 65+ years. Enrolment: 362.
Status: Ended. Start date (EU): 2020-05-25. End date (EU): 2026-06-19. End date: 2026-06-25. Decision date: 2024-02-05. Results received: No. Last updated: 2026-05-19.
Decision dates by country: NL: 2024-02-06, SE: 2024-02-06, PL: 2024-02-09, ES: 2024-02-05, DE: 2024-02-07, FR: 2024-02-09, IT: 2024-02-08, GR: 2024-02-12

Condition(s): Previously treated locally advanced and unresectable or metastatic non-small cell lung cancer (NSCLC) with KRAS p.G12C mutation
Product: SOTORASIB, Dexamethasone 2mg Tablets, DOCETAXEL

Primary endpoint: PFS - defined as time from randomization until disease progression or death from any cause, whichever occurs first for all subjects. Progression will be based on blinded independent central review (BICR) of disease response per Response Evaluation Criteria in Solid Tumors version 1.1 (RECIST v1.1).
Endpoint(s): Overall survival - defined as time from randomization until death from any cause., Objective response (complete response [CR] + partial response [PR]), assessed per RECIST v1.1. Response will be assessed by BICR. Complete response and PR require confirmatory repeat radiologic assessment at no less than 4 weeks after the original response. The normal subsequent assessment is acceptable to confirm response., Change from baseline (cycle 1 day 1) over time to week 12 in disease related symptoms of: - Dyspnea as measured by a 4-item dyspnea domain from QLQ-C30 and QLQ-LC13 - Cough as measured by QLQ-LC13 - Chest Pain as measured by QLQ-LC13, Change from baseline over time to week 12 in: - Physical functioning as measured by QLQ-C30 - Global health status as measured by QLQ-C30

Source: https://euclinicaltrials.eu/ctis-public/view/2023-508214-42-00